EU clinical trial 2024-519941-32-00: A SINGLE-ARM, OPEN-LABEL, PHASE II STUDY TO DETERMINE THE SAFETY AND EFFICACY OF OBECABTAGENE AUTOLEUCEL (OBE-CEL) IN PARTICIPANTS WITH SEVERE, REFRACTORY SYSTEMIC LUPUS ERYTHEMATOSUS WITH ACTIVE LUPUS NEPHRITIS
Protocol code: AUTO1-SL2
Sponsor: Autolus Limited (Pharmaceutical company). Phase: Therapeutic exploratory (Phase II). Countries: Greece (authorised, recruitment pending).
Therapeutic area(s): Diseases [C] - Immune System Diseases [C20]
Gender: Female, Male. Age: 18-64 years. Enrolment: 3.
Status: Authorised, recruitment pending. Decision date: 2025-11-20. Results received: No. Last updated: 2026-06-11.

Condition(s): Systemic Lupus Erythematosus with Active Lupus Nephritis
Product: AUTO1, Cyclophosphamide 500 mg Powder for Solution for Injection or Infusion, Fludara 50 mg powder for solution for injection or infusion

Primary endpoint: Proportion of participants with CRR, defined as: • Urine Protein Creatinine Ratio (UPCR) ≤ 0.5 mg/mg AND • Estimated glomerular filtration rate (eGFR) ≥ 60 mL/min/1.73 m2 or no decrease from baseline eGFR of > 20% AND • Did not receive rescue medicine Time frame: Month 6
Endpoint(s): Remission rate as specified by DORIS Time Frame: Month 6, Proportion of participants with CRR. Time Frame: Up to Month 24, Time to CRR. Time Frame: Up to Month 24, Duration of CRR. Time Frame: Up to Month 24, Proportion of participants with PRR, defined as: • ≥ 50% reduction in UPCR from baseline Time Frame: Up to Month 24, Time to PRR. Time Frame: Up to Month 24, Duration of PRR. Time Frame: Up to Month 24, Remission over time, time to response, as specified by DORIS Time Frame: Up to Month 24, Time to renal event. Renal event defined as: • Confirmed decrease from baseline in eGFR (pre-specified as a > 30% decrease) Time Frame: Up to Month 24, SLEDAI-2K score over time and proportion of participants achieving SLEDAI-2K score of 0. Time Frame: Up to Month 24, Remission over time, time to remission, and duration of remission as specified by the definition of remission in LLDAS. Time Frame: Up to Month 24, Time from obe-cel infusion to first disease flare as specified by the definition of flare in SFI NOTE: SLEDAI-2K will be used to score SFI. Time Frame: Up to Month 24, Change from baseline in PGA Time Frame: Up to Month 24, Change from baseline in FACIT-Fatigue score Time Frame: Up to Month 24, Change from baseline in HAQ-DI Time Frame: Up to Month 24, Change from baseline in SF-36 Time Frame: Up to Month 24, Change from baseline in EQ-5D Time Frame: Up to Month 24, Frequency and duration of hospitalization and/or critical care support to manage obe-cel-related toxicity Time Frame: Up to Month 24, Frequency, severity and duration of CRS, ICANS, and other identified risks Time Frame: Up to Month 24, Adverse event (AE) type, frequency, severity, and relationship with obe-cel or lymphodepletion, safety laboratory samples, vital signs Time Frame: Up to Month 24, Detection of CAR T cells Time Frame: 9 timepoints post-infusion between Days 1 and 28, followed by Month 2, Month 3, then 3-monthly to month 24, Change from baseline in serum autoantibody concentration (antinuclear antibody [ANA], anti-double stranded DNA [anti-dsDNA], anti-Smith, anti-RNA binding protein [anti-RBP]) Time Frame: Pre-infusion at Day -6 and post-infusion at Day 28, Month 3, then 3-monthly to Month 12 and 6-monthly to Month 24, Change from baseline in the complement panel (complement, total [CH50], C3, C4) Time Frame: Pre-infusion at Day -6 and post-infusion at Day 28, Month 3, then 3-monthly to Month 12 and 6-monthly to Month 24, Change from baseline in PtGA Time Frame: Up to Month 24, Detection of B cells in the peripheral blood over time Time Frame: Pre-infusion at screening and Day -6 and post-infusion at Day 1, Day 28, Month 2, Month 3, then 3-monthly to Month 12 and 6-monthly to Month 24, Change from baseline in the antiphospholipid profile (lupus anticoagulant, anticardiolipin antibodies and beta-2 glycoprotein) Time Frame: Pre-infusion at Day -6 and post-infusion at Day 28, Month 3, then 3-monthly to Month 12 and 6-monthly to Month 24

Source: https://euclinicaltrials.eu/ctis-public/view/2024-519941-32-00